EU clinical trial 2022-501392-81-00: DUTCH Weight Control in Atrial Fibrillation Study
Protocol code: 2022-501392-81-00
Sponsor: Stichting Rijnstate Ziekenhuis (Hospital/Clinic/Other health care facility). Phase: Therapeutic use (Phase IV). Countries: Netherlands (ongoing, recruitment ended).
Therapeutic area(s): Diseases [C] - Nutritional and Metabolic Diseases [C18]; Diseases [C] - Cardiovascular Diseases [C14]
Gender: Female, Male. Age: 18-64 years, 65+ years. Enrolment: 280.
Status: Ongoing, recruitment ended. Start date (EU): 2024-07-25. Decision date: 2024-06-13. Results received: No. Last updated: 2026-07-27.

Condition(s): Atrial fibrillation, Obesity
Product: semaglutide, PDS290 Semaglutide placebo

Primary endpoint: For all patients, the one-year rhythm outcome status is ranked according to severity, from the most severe to the least severe outcome, as follows: Arrhythmic death while on Vaughn-Williams class I or III (VW-I/III) anti-arrhythmic drugs (AAD) In Atrial fibrillation (AF) after pulmonary vein isolation (PVI) In AF and on VW-I/III AAD In AF and not on VW-I/III AAD In Sinus Rhythm (SR) after PVI In SR and on VW-I/III AAD In SR and not on VW-I/III AAD, The second primary endpoint of the trial is the occurrence of any of the following at or within 12 months after randomization Persistent AF on the ECG at the 12-month visit Catheter ablation for AF Arrhythmic death Any serious adverse event due to an anti-arrhythmic drug This second primary endpoint will be statistically assessed as a binary (yes/no) variable.
Endpoint(s): Change in AF related symptoms measured by the modified EHRA score between the index visit and at 12 months after the index visit., Change in quality of life measured by the EQ-5D-5L between the index visit and at 12 months after the index visit., Number of hospitalizations because of an AF recurrence., Number of unscheduled hospital visits because of adverse events of AAD., Number of scheduled electrical cardioversions., Number of unscheduled electrical cardioversions., Number of intravenous chemical cardioversions (using Vaughan-Williams class I drugs)., Total number of unscheduled cardioverions, Change in waist circumference, measured in cm (time frame: week 0 and 52)., Change in weight, measured in % and kg (time frame: week 0 and 52), Change in BMI, measured in kg/m2 (time frame: week 0 and 52)., Change in systolic blood pressure, measured in mmHg (time frame: week 0 and 52)., Change in diastolic blood pressure, measured in mmHg (time frame: week 0 and 52)., Change in HbA1c, measured in % and mmol/L (time frame: week 0 and 52), Change in lipids (total cholesterol, LDL, HDL and triglycerides), measured in mmol/L (time frame: week 0 and 52), Change in CRP, measured in mg/L (time frame: week 0 and 52)., Change in NT-pro BNP, measured pmol/L (time frame: week 0 and 52), Change in work productivity measured by the Work Productivity and Activity Index, between the index visit and at 12 months after the index visit., Change in exercise motivation using the Behavioral Regulation and Exercise Questionnaire 2 between the index visit and at 12 months after the index visit., Difference in total cost of all healthcare expenditures related to the management of atrial fibrillation, in Euros.

Source: https://euclinicaltrials.eu/ctis-public/view/2022-501392-81-00